EU clinical trial 2024-512465-14-00: 18F-FES PET/MRI for tailoring treatment of luminal A and lobular breast cancer: a phase II trial evaluating the performance of FES PET/MRI in axillary staging
Protocol code: FESTA
Sponsor: Universita' Vita-salute S. Raffaele (Educational Institution). Phase: Therapeutic exploratory (Phase II). Countries: Italy (ongoing, recruiting).
Therapeutic area(s): Diseases [C] - Neoplasms [C04]
Gender: Female. Age: 18-64 years, 65+ years. Enrolment: 221.
Status: Ongoing, recruiting. Start date (EU): 2026-06-09. Decision date: 2024-07-04. Results received: No. Last updated: 2026-03-27.

Condition(s): Primary or advanced breast cancer LumA or ER+ Lobular subtypes.

Primary endpoint: Sensitivity (SE) of FES PET/MRI and axillary ultrasound (US) to detect macrometastatic (tumor deposit>2mm) axillary lymph nodes with the goal of demonstrating the superiority of FES PET/MRI over US.
Endpoint(s): Specificity, positive predictive value, negative predictive value, and overall accuracy of FES PET/MRI., Comparison FES PET/MRI vs standard imaging. Results from FES PET/MRI will be compared with standard imaging in terms of sensitivity and number of lesions with FES uptake versus previously known lesions from all preoperative exams (mammography, ultrasound or any exam performed as preoperative routine)., Correlation between recurrence score and FES PET/MRI findings and parameters will be investigated. This analysis will include a subset of patients for whom Oncotype DX will be performed after surgery according to standard indications. The recurrence score will be correlated to the quantitative imaging PET parameters (SUVmax, SUVmean, MTV, TLG).

Source: https://euclinicaltrials.eu/ctis-public/view/2024-512465-14-00